EU clinical trial 2023-507837-18-00: An open-label, multicenter, prospective, single-arm, exploratory study to assess role of pancreatic enzyme replacement therapy (PERT) (Creon® 25,000) in patients with Pancreatic Exocrine Insufficiency (PEI) after total gastrectomy.
Sponsor: BGP Products Operations GmbH (Pharmaceutical company). Phase: Therapeutic use (Phase IV). Countries: Portugal (ongoing, recruitment ended), Poland (ongoing, recruitment ended), Spain (ongoing, recruitment ended).
Therapeutic area(s): Diseases [C] - Digestive System Diseases [C06]
Gender: Female, Male. Age: 18-64 years, 65+ years. Enrolment: 61.
Status: Ongoing, recruitment ended. Start date (EU): 2025-03-06. Decision date: 2025-01-15. Results received: No. Last updated: 2026-05-29.
Decision dates by country: ES: 2025-01-15, PT: 2025-01-21, PL: 2025-01-21

Condition(s): Male and female patients aged ≥ 18 to ≤ 80 after total gastrectomy.
Product: Creon® 25000 Capsules

Primary endpoint: Proportion of patients on stable dose of Creon, in whom there is no deterioration of nutritional status (as measured by no loss of body weight from baseline Visit).
Endpoint(s): Change in bodyweight from baseline, Percentage of patients who develop symptomatic pancreatic exocrine insufficiency after gastrectomy., Symptoms of pancreatic exocrine insufficiency measured (as recorded in subject diaries), Nutritional parameters, Gastrointestinal Quality of life index (GIQLI) questionnaire, Treatment Emergent Adverse Events (TEAEs), Change in vital signs

Source: https://euclinicaltrials.eu/ctis-public/view/2023-507837-18-00